EU clinical trial 2023-507466-40-00: PEnile ReHAbilitation (PEHAB) After Nerve Sparing Robot-assisted Radical Prostatectomy for Prostate Cancer 2.0, a Multicenter, Randomized Clinical Trial
Sponsor: Het Nederlands Kanker Instituut-Antoni van Leeuwenhoek Ziekenhuis Stichting (Hospital/Clinic/Other health care facility). Phase: Therapeutic use (Phase IV). Countries: Netherlands (ongoing, recruiting).
Therapeutic area(s): Diseases [C] - Male Urogenital Diseases [C12]
Gender: Female, Male. Age: 18-64 years, 65+ years. Enrolment: 220.
Status: Ongoing, recruiting. Start date (EU): 2024-01-12. Decision date: 2023-12-08. Results received: No. Last updated: 2026-06-18.

Condition(s): Prostate cancer
Product: Androskat, Sildenafil Viatris 50 mg filmomhulde tabletten, Sildenafil Viatris 100 mg filmomhulde tabletten, Sildenafil Viatris 25 mg filmomhulde tabletten

Primary endpoint: To evaluate the rates of return to adequate spontaneous unassisted erections at 24 months after nerve-sparing radical prostatectomy (nsRP) following a 12-month program of either daily sildenafil (75/100mg) and vacuum erection device (VED) therapy five times a week or Sildenafil(75/100mg) on-demand (≤3 times a week).
Endpoint(s): Erectile function endpoints: • The return to baseline erection rate 24 months after nsRP according to the IIEF-EF or EPIC-erection function and EHS, comparing two different penile rehabilitation programmes., Erectile function endpoints: • The time to recovery of erectile function using IIEF-EF or EPIC-erection function and EHS, comparing two different penile rehabilitation programmes., Erectile function endpoints: • The rates of achieving good unassisted erections at 18 months according to IIEF-EF or EPIC-erection function and EHS, comparing two different penile rehabilitation programmes., Erectile function endpoints: • The rate of patients achieving good assisted erections at 6, 9, 12, and 18 months according to IIEF-EF or EPIC-erection function and EHS, comparing two different penile rehabilitation programs. The stretched penile length at 12 months compared to baseline., Health related and sexual quality of life endpoints: • Other sexual function scores (i.e. orgasmic function), feelings of masculinity and health-related quality of life scores between the treatment groups and between hetero versus gay/bisexual patients over time. Using IIEF-15 domains, EPIC-sexual domain, QLQC30, PRP-25 and two self-composed masculinity and gay/bisexual inventory at baseline, 12 months and 24 months., Health related and sexual quality of life endpoints: • The effects of climacturia between the groups. Using a self- designed questionnaire based on validated questionnaires. Measurements will take place 12 months and 24 months after surgery., Health related and sexual quality of life endpoints: • The partner interaction between the treatment groups. Using a self-designed questionnaire based on validated questionnaires. At baseline, 12 months and 24 months., Adherence and side effects endpoints: • The adherence to the penile rehabilitation programs during the first 12 months of follow-up. Taking into account noted side effects and frequency of use of the prescribed treatment strategies. Using a self-de- signed questionnaire based on validated questionnaires., Best tool to evaluate erectile function endpoint: • The pre-operative IIEF-EF and EPIC-sexual domain scores between patients who are engaged in sexual intercourse and those who are not., Partner endpoints: • Satisfaction with rehabilitation program from partners’ perspective at 12 months and 24 months. • The partner interaction between the treatment groups from partners’ perspective. Using a self-designed questionnaire based on validated questionnaires at baseline and 24 months after surgery. • Sexual health related quality of life scores of partners between the different treatment groups. Using EORTC QLQ-SH22 at baseline at 12 months and 24 months after surgery.

Source: https://euclinicaltrials.eu/ctis-public/view/2023-507466-40-00